EU clinical trial 2024-513447-82-00: Activity and safety of peptide-based immunotherapy in an umbrella window of opportunity phase II study in patients with squamous cell carcinoma of the head and neck.
Protocol code: HN1901
Sponsor: Cliniques Universitaires Saint-Luc (Hospital/Clinic/Other health care facility). Phase: Therapeutic exploratory (Phase II). Countries: Belgium (ended).
Therapeutic area(s): Diseases [C] - Otorhinolaryngologic Diseases [C09]
Gender: Female, Male. Age: 18-64 years, 65+ years. Enrolment: 39.
Status: Ended. End date (EU): 2025-03-20. Decision date: 2024-09-18. Results received: Yes. Last updated: 2024-09-18.

Condition(s): squamous cell carcinoma of the head and neck
Product: IO103 + Montanide, IO102 + Montanide, IO102 + IO103 + Montanide

Primary endpoint: ELISpot responses will be considered positive when the numbers of IFN-γ secreting cells will be at least two-fold greater than the mean value of the baseline with a minimum of 50 spots (per 2-5 × 105 PBMC) detected
Endpoint(s): Arm A (IO102 vaccine) : 1) Safety, tolerability of IO102, as assessed by AEs, clinical laboratory tests, physical examination results using CTC-NCIv5.0., Arm A (IO102 vaccine) : 2) Evaluation of the increased tumoral infiltration by CD3+ and CD8+ T-lymphocytes and by measuring the serum levels of kynurenin, tryptophan and kynurenin/tryptophan ratio., Arm A (IO102 vaccine) : 3) Objective response rate (ORR), Overall survival (OS), Disease Free-Survival (DFS), Disease Specific Survival (DSS), Arm A (IO102 vaccine) : 4) To investigate the efficacy of IO102 in monotherapy using MRI and DWI-MRI to visualize possible significant tumor modifications, Arm C (IO103 vaccine) : 1) Safety, tolerability of IO103, as assessed by AEs, clinical laboratory tests, physical examination results using CTC-NCIv5.0, Arm C (IO103 vaccine) : 2) Evaluation of the increased tumoral infiltration by CD3+ and CD8+ T-lymphocytes, Arm C (IO103 vaccine) : 3) Objective response rate (ORR), Overall survival (OS), Disease Free-Survival (DFS), Disease Specific Survival (DSS), Arm C (IO103 vaccine) : 4) To investigate the efficacy of IO103 in monotherapy using MRI and DWI-MRI to visualize possible significant tumor modifications, Arm D (IO102+IO103 vaccines) : 1) Safety, tolerability of IO102+IO103, as assessed by AEs, clinical laboratory tests, physical examination results using CTC-NCIv5.0., Arm D (IO102+IO103 vaccines) : 2) Evaluation of the increased tumoral infiltration by CD3+ and CD8+ T-lymphocytes by measuring the serum levels of kynurenin, tryptophan and kynurenin/tryptophan ratio., Arm D (IO102+IO103 vaccines) : 3) Objective response rate (ORR), Overall survival (OS), Disease Free-Survival (DFS), Disease Specific Survival (DSS), Arm D (IO102+IO103 vaccines) : 4) To investigate the efficacy of IO102+IO103 in monotherapy using MRI and DWI-MRI to visualize possible significant tumor modifications

Source: https://euclinicaltrials.eu/ctis-public/view/2024-513447-82-00